EU clinical trial 2023-505674-15-00: A Phase 3, Randomized, Open-label, Parallel-arm, Active-controlled, Multicenter Study to Evaluate Safety and Efficacy of ALXN1850 Versus Asfotase Alfa Administered Subcutaneously in Pediatric Participants (2 to < 12 years of age) with Hypophosphatasia (HPP) Previously Treated with Asfotase Alfa (Chestnut)
Protocol code: ALXN1850-HPP-303
Sponsor: Alexion Pharmaceuticals Inc. (Pharmaceutical company). Phase: Therapeutic confirmatory (Phase III). Countries: Italy (not authorised), France (not authorised), Germany (revoked).
Therapeutic area(s): Diseases [C] - Musculoskeletal Diseases [C05]
Gender: Female, Male. Age: 0-17 years. Enrolment: 7.
Decision date: 2024-04-16. Results received: No. Last updated: 2024-04-17.
Decision dates by country: FR: 2024-04-17, DE: 2024-04-16, IT: 2024-04-17

Condition(s): Hypophosphatasia
Product: ALXN1850, Strensiq 40 mg/ml Solution for Injection, Strensiq 100 mg/ml Solution for Injection

Primary endpoint: Incidence of TEAEs, TESAEs, AESIs and AEs leading to study intervention discontinuation or interruption
Endpoint(s): RGI-C score at the end of the Randomized Evaluation Period (Day 169), Change from baseline in RSS at the end of the Randomized Evaluation Period (Day 169), Change from baseline in 6MWT at the end of the Randomized Evaluation Period (Day 169) (≥ 5 years of age), Change from baseline in % Predicted 6MWT at the end of the Randomized Evaluation Period (Day 169) (≥ 5 years of age), Change from baseline in BOT-2 at the end of the Randomized Evaluation Period (Day 169) (≥ 4 years of age), Change from baseline in PDMS-3 at the end of the Randomized Evaluation Period (Day 169) (< 4 years of age), Change from baseline at the end of the Randomized Evaluation Period (Day 169) in the following:- EQ-5D-Y health state score (≥ 8 years of age)- EQ-5D-Y-Proxy Version 1 health state score (≥ 4 to < 8 years of age)- PODCI Self-Report global function score (≥ 11 years of age)- PODCI-Parent global function score (< 11 years of age)- APPT score (≥ 8 years of age)- Pediatric FACIT-Fatigue score (≥ 8 years of age)- Pediatric FACIT-Fatigue Proxy score (≥ 2 to < 8 years of age), TSQM-9 score at the end of the Randomized Evaluation Period (Day 169), Plasma ALXN1850 and asfotase alfa concentration or activity at predose or trough (Ctrough) over time through the end of the Randomized Evaluation Period (Day 169), Plasma PPi, PLP, PA, and PLP/PL concentration or ratio and change from baseline over time through the end of the Randomized Evaluation Period (Day 169), ADA incidence, ADA response categories, and ADA titer, as well as NAb incidence and NAb titers in participants treated with ALXN1850 or asfotase alfa, as appropriate.

Source: https://euclinicaltrials.eu/ctis-public/view/2023-505674-15-00